EU clinical trial 2025-522944-41-00: A Modular, Open Label, Dose Finding Phase 1/2 Clinical Trial in Patients with Solid Tumours to Assess the Safety, Tolerability, Pharmacokinetics, Pharmacodynamics, and Preliminary Efficacy of PTT-4256 (RAISIC-1: Relief of Acidic Immune Suppression In Cancer)
Protocol code: PTT-4256-01
Sponsor: Pathios Therapeutics Limited (Pharmaceutical company). Phase: Phase I and Phase II (Integrated)- First administration to humans. Countries: France (authorised, recruitment pending), Spain (authorised, recruitment pending).
Therapeutic area(s): Not possible to specify
Gender: Female, Male. Age: 18-64 years, 65+ years. Enrolment: 95.
Status: Authorised, recruitment pending. Decision date: 2026-02-27. Results received: No. Last updated: 2026-03-02.
Decision dates by country: ES: 2026-03-02, FR: 2026-02-27

Condition(s): Solid Tumours
Product: PTT-4256, OPDIVO 10 mg/mL concentrate for solution for infusion., PTT-4256, PTT-4256, PTT-4256, PTT-4256

Primary endpoint: Incidence, nature, and severity of AEs, SAEs, and TEAEs.
Endpoint(s): • Incidence, nature, and severity of AEs, SAEs, and TEAEs., • Tumour response assessment by cross-sectional imaging: objective response rate (ORR), disease control rate (DCR), duration of response (DoR), and progression free survival (PFS) as assessed by RECIST v1.1 and/or iRECIST (if applicable) criteria, based on Investigator assessment, • Overall survival (OS) as assessed during study participation and via telephone follow-ups every 3 months thereafter., • Plasma PK parameters, including but not limited to: Cmin, Cmin_ss, and accumulation ratio (RA Cmin).

Source: https://euclinicaltrials.eu/ctis-public/view/2025-522944-41-00